EU clinical trial 2024-515362-13-00: Apixaban/rivaroxaban Versus Aspirin for primary prevention of thrombo-embolic complications in JAK2V617F-positive myeloproliferative neoplasms
Protocol code: 29BRC20.0263
Sponsor: Centre Hospitalier Regional Et Universitaire De Brest (Hospital/Clinic/Other health care facility). Phase: Phase II and Phase III (Integrated). Countries: France (authorised, recruiting).
Therapeutic area(s): Diseases [C] - Neoplasms [C04]
Gender: Female, Male. Age: 18-64 years, 65+ years. Enrolment: 1008.
Status: Authorised, recruiting. Start date (EU): 2024-08-01. Decision date: 2024-08-01. Results received: No. Last updated: 2025-07-11.

Condition(s): Philadelphia-negative myeloproliferative neoplasms are frequent and chronic myeloid malignancies including Polycythemia Vera (PV), essential thrombocythemia (ET), Primary Myelofibrosis (PMF) and Prefibrotic myelofibrosis (PreMF).
Product: RESITUNE 100 mg, comprimé gastro-résistant, Xarelto 10 mg film-coated tablets, ASPIRINE PROTECT 100 mg, comprimé gastro-resistant, Eliquis 2.5 mg film-coated tablets, ACIDE ACETYLSALICYLIQUE VIATRIS 100 mg, comprimé gastro-résistant, ASPIRINE ARROW 100 mg, comprimé gastro-résistant

Primary endpoint: Time to occurrence of arterial or venous thromboembolic events
Endpoint(s): Time to occurrence of major and clinically relevant non-major bleedings as defined by ISTH, Time to occurrence of arterial thromboembolic events, Time to occurrence of venous thromboembolic events, Time to occurrence of thromboembolic and bleeding events according to PV or ET or PreMF status, Time to occurrence of thromboembolic and bleeding events according to the cytoreductive associated drugs, Time to occurrence of serious adverse events others than thromboses and hemorrhages, Occurrence of atrial fibrillation episodes (time to occurrence), Overall survival and event free survival (events defined above) at 24 months, Adjudicated mortality (non-cardiovascular and cardiovascular), time to occurence, Therapeutic adherence will be studied (Girerd auto-questionnaire) during the study treatment period of 24 months, Quality of life will be studied (EQ-5D-5L and MPN-SAF-TSS auto-questionnaire) during the study treatment period of 24 months, Evaluation of costs and incremental cost utility ratio (cost per QALY) of low-dose DOAC compared to LDA

Source: https://euclinicaltrials.eu/ctis-public/view/2024-515362-13-00